EU clinical trial 2023-505807-21-00: Phase III Randomized, Open-Label, Multicenter Study Evaluating Efficacy and Safety of Mosunetuzumab in Combination with Lenalidomide in Comparison to Rituximab in Combination with Lenalidomide with a Non-Randomized, Single Arm US Extension of Mosunetuzumab in Combination with Lenalidomide in Patients with Follicular Lymphoma After at Least One Line of Systemic Therapy
Protocol code: GO42909
Sponsor: F. Hoffmann-La Roche AG (Pharmaceutical company). Phase: Therapeutic confirmatory (Phase III). Countries: France (ongoing, recruitment ended), Italy (ongoing, recruitment ended), Germany (ongoing, recruitment ended), Spain (ongoing, recruitment ended), Poland (ongoing, recruitment ended).
Therapeutic area(s): Diseases [C] - Neoplasms [C04]
Gender: Female, Male. Age: 18-64 years, 65+ years. Enrolment: 150.
Status: Ongoing, recruitment ended. Start date (EU): 2021-11-16. Decision date: 2024-11-07. Results received: No. Last updated: 2026-07-01.
Decision dates by country: ES: 2024-11-07, IT: 2024-11-18, PL: 2024-11-11, DE: 2024-11-13, FR: 2024-12-03

Condition(s): Relapsed/refractory follicular lymphoma

Primary endpoint: Arm A and Arm B : 1. Progression-free survival as determined by the IRC with use of the 2014 Lugano Response Criteria or death from any cause in the intent-to-treat (ITT) population, Arm C : 2. Objective response rate, as defined as the proportion of patients whose best overall response is a PR or a CR during the study, as determined by the IRC
Endpoint(s): 1. Arm A and Arm B: Progression-free survival as determined by the investigator in the ITT population. Arm C: Progression-free survival as determined by the investigator and IRC in the ITT population., 2. Arm A, Arm B and Arm C: Complete response rate in the ITT population as determined by the IRC and investigator, 3. Arm A, Arm B and Arm C: Objective response rate in the ITT population as determined by the IRC and investigator, 4. Arm A, Arm B and Arm C: Overall survival in the ITT population, 5. Arm A, Arm B and Arm C: Duration of objective response (DOR), 6. Arm A, Arm B and Arm C: Duration of CR, 7. Arm A, Arm B and Arm C: Time to deterioration in physical functioning as measured by the European Organization for Research and Treatment of Cancer Quality of Life-Core 30 Questionnaire (EORTC QLQ-C30), 8. Arm A, Arm B and Arm C: Time to deterioration in fatigue, as measured by the EORTC QLQC30, 9. Arm A, Arm B and Arm C: Time to deterioration in lymphoma symptoms, as measured by the Functional Assessment of Cancer Therapy-Lymphoma Subscale (FACT-LymS), 10. Arm A, Arm B and Arm C : Time to new anti-lymphoma treatment (TTNALT), defined as the time from randomization to the first documented administration of a new anti-lymphoma treatment, 11. Arm A, Arm B and Arm C: Incidence and severity of adverse events, with severity determined according to the NCI CTCAE, v5.0, including cytokine release syndrome (CRS), with severity determined according to the American Society for Transplantation and Cellular Therapy (ASTCT) CRS grading criteria, 12. Arm A, Arm B and Arm C: Change from baseline in targeted vital signs, 13. Arm A, Arm B and Arm C: Change from baseline in targeted clinical laboratory test results, 14. Arm A, Arm B and Arm C: Tolerability, as assessed by dose interruptions, dose reductions, and dose intensity, and study treatment discontinuation because of adverse events, 15. Arm A, Arm B and Arm C: Minimum observed concentration (Cmin) of Mosunetuzumab, 16. Arm A, Arm B and Arm C: Cmin of Lenalidomide, 17. Arm A, Arm B and Arm C: Maximum observed concentration (Cmax) of Mosunetuzumab, 18. Arm A, Arm B and Arm C: Cmax of Lenalidomide, 19. Arm A, Arm B and Arm C: Area under the concentration-time curve (AUC) of Mosunetuzumab, 20. Arm A, Arm B and Arm C: AUC of Lenalidomide, 21. Arm A, Arm B and Arm C: Prevalence of anti-drug antibodies (ADAs) against mosunetuzumab at baseline, 22. Arm A and Arm B: Prevalence of ADAs against rituximab at baseline, 23. Arm A, Arm B and Arm C: Incidence of ADAs against mosunetuzumab during the study, 24. Arm A and Arm B: Incidence of ADAs against rituximab during the study, 25. Arm A and Arm B: Cmin of Rituximab, 26. Arm A and Arm B: Cmax of Rituximab, 27. Arm A and Arm B: AUC of Rituximab

Source: https://euclinicaltrials.eu/ctis-public/view/2023-505807-21-00